EU clinical trial 2024-519068-42-00: An Operationally Seamless Phase 2/3 Study to Evaluate the Safety, Efficacy, and Pharmacokinetics of Enlicitide Decanoate in Pediatric Participants with Heterozygous Familial Hypercholesterolemia
Protocol code: MK-0616-029
Sponsor: Merck Sharp & Dohme LLC (Pharmaceutical company). Phase: Phase II and Phase III (Integrated). Countries: Germany (authorised, recruiting), Spain (authorised, recruiting), Belgium (authorised, recruiting), Czechia (ongoing, recruiting), Norway (authorised, recruitment pending), France (authorised, recruitment pending), Poland (authorised, recruitment pending), Netherlands (ongoing, recruiting), Italy (authorised, recruitment pending), Finland (authorised, recruiting).
Therapeutic area(s): Diseases [C] - Cardiovascular Diseases [C14]
Gender: Female, Male. Age: 0-17 years. Enrolment: 36.
Start date (EU): 2026-02-12. Decision date: 2026-01-26. Results received: No. Last updated: 2026-03-16.
Decision dates by country: CZ: 2026-01-29, FR: 2026-01-28, DE: 2026-01-27, IT: 2026-01-26, ES: 2026-01-29, NL: 2026-01-26, NO: 2026-01-30, PL: 2026-01-30, FI: 2026-02-02, BE: 2026-01-30

Condition(s): Heterozygous Familial Hypercholesterolemia in pediatric patients
Product: MK-0616, Placebo to MK-0616

Primary endpoint: Maximum Plasma Concentration (Cmax) of Enlicitide for Part A (Age Cohort 1), Maximum Plasma Concentration (Cmax) of Enlicitide for Part A (Age Cohort 2), Area Under the Concentration-time Curve From 0 to 24 (AUC0-24) Hours of Enlicitide for Part A (Age Cohort 1), Area Under the Concentration-time Curve From 0 to 24 (AUC0-24) Hours of Enlicitide for Part A (Age Cohort 2), Percent Change From Baseline in Low-Density Lipoprotein Cholesterol (LDL-C) at Week 24 in Part B Participants, Percent Change From Baseline in LDL-C at Week 24 in Part B Age Cohort 1 Participants, Number of Participants With One or More Adverse Events (AEs), Number of Participants Who Discontinue Study Treatment Due to an AE
Endpoint(s): Percentage Change From Baseline in Apolipoprotein B (ApoB) at Week 24 in Part B Participants, Percentage Change From Baseline in Non-High-Density Lipoprotein Cholesterol (Non-HDL-C) at Week 24 in Part B Participants, Percentage Change From Baseline in Lipoprotein (a) [Lp (a)] at Week 24 in Part B Participants, Proportion of Participants With LDL-C <130 mg/dL (3.37 mmol/L) at Week 24 in Part B Participants, Proportion of Participants LDL-C ≥50% Reduction From Baseline at Week 24 in Part B Participants, Proportion of Participants With LDL-C <100 mg/dL (2.59 mmol/L) at Week 24 in Part B Participants, Change in Ultrasound Determined Mean cIMT at Week 24 in Part B Participants

Source: https://euclinicaltrials.eu/ctis-public/view/2024-519068-42-00